EU clinical trial 2023-508585-15-00: Optimization of Albuminuria-Lowering Therapies for Individual Patients with Type 2 Diabetes Using Empagliflozin and Finerenone in a Pilot Remote Clinical Trial
Protocol code: 18253
Sponsor: Universitair Medisch Centrum Groningen (Hospital/Clinic/Other health care facility). Phase: Therapeutic use (Phase IV). Countries: Netherlands (ended).
Therapeutic area(s): Diseases [C] - Hormonal diseases [C19]; Diseases [C] - Nutritional and Metabolic Diseases [C18]; Diseases [C] - Pathological Conditions, Signs and Symptoms [C23]
Gender: Female, Male. Age: 18-64 years, 65+ years. Enrolment: 10.
Status: Ended. Start date (EU): 2024-07-29. End date (EU): 2025-09-24. Decision date: 2024-04-25. Results received: No. Last updated: 2024-04-25.

Condition(s): Albuminuria, Type 2 diabetes
Product: Kerendia 20 mg film-coated tablets, Kerendia 10 mg film coated tablets, Jardiance 10 mg film-coated tablets

Primary endpoint: Questionnaire results: participants’ perspectives toward the feasibility of participation in a trial at home with digital technologies, Number and percentage of urine collections not received at the laboratory or unable to be analyzed, Number and percentage of missed blood pressure or body weight measurements, Treatment adherence: pill count and medication concentration in urine samples
Endpoint(s): Change from baseline in UACR from start to end of treatment with empagliflozin, Change from baseline in systolic blood pressure, body weight, eGFR, and fasting plasma glucose from start to end of treatment with empagliflozin, (Additive) treatment effects on UACR, systolic blood pressure, body weight, eGFR, and fasting plasma glucose from start to end of treatment after the addition or substitution with finerenone

Source: https://euclinicaltrials.eu/ctis-public/view/2023-508585-15-00